EU clinical trial 2025-523166-24-00: SPRAYDYE-Trial - A phase I/II study to assess the efficacy, safety and tolerability of topically applied 6qc-ICG, a cathepsin-activatable fluorescent probe, for real-time intraoperative resection margin assessment in breast conserving surgery
Protocol code: SPRAYDYE / CHDR2535
Sponsor: Leids Universitair Medisch Centrum (LUMC) (Hospital/Clinic/Other health care facility). Phase: Phase I and Phase II (Integrated)- First administration to humans. Countries: Netherlands (authorised, recruitment pending).
Therapeutic area(s): Diseases [C] - Neoplasms [C04]; Phenomena and Processes [G] - Physiological processes [G07]
Gender: Female, Male. Age: 18-64 years, 65+ years. Enrolment: 22.
Status: Authorised, recruitment pending. Decision date: 2025-12-22. Results received: No. Last updated: 2026-03-12.

Condition(s): Breast cancer
Product: 6QC-ICG, Placebo for 6QC-ICG

Primary endpoint: Local tolerability assessment, LIGS score, Numeric rating scales pain and pruritus, Local treatment-emergent (serious) adverse events ((S)AEs), Systemic treatment-emergent (serious) adverse events ((S)AEs) throughout the study, Vital signs (pulse rate (bpm), systolic blood pressure (mmHg), diastolic blood pressure (mmHg)) as per assessment schedule, Clinical laboratory tests (hematology, blood chemistry and urinalysis) as per assessment schedule, ECG parameters (heart rate (HR) (bpm), PR, QRS, QT, QTcF) as per assessment schedule, Concomitant medication
Endpoint(s): PK- parameters of 6qc-ICG by multi-compartmental analysis of the plasma concentration-time data and urine data: o AUCinf, AUClast, CL/F, Cmax, t1/2, tlag, tmax, Vz/F o Dose-normalized PK parameters: AUCinf, AUClast, Cmax o Urine PK parameters: Aelast, Aelast%, CLR, Status of wound closure over time, Analysis of NIR fluorescence images of all the surgical cavity walls: o Fluorescent yes or no o Tumor in biopsy of fluorescent area yes or no o No tumor-positive margins at pathology at the location of fluorescent-negative cavity walls yes or no o Signal-to-background ratio (SBR) of fluorescent area

Source: https://euclinicaltrials.eu/ctis-public/view/2025-523166-24-00